EU clinical trial 2024-510745-34-00: A Multicenter, Randomized, Double-Blind, Placebo-Controlled, Parallel Group Study to Evaluate the Efficacy and Safety of Dupilumab in Adult Patients with Bullous Pemphigoid
Protocol code: R668-BP-1902
Sponsor: Regeneron Pharmaceuticals Inc. (Pharmaceutical company). Phase: Phase II and Phase III (Integrated). Countries: France (ended), Poland (ended), Germany (ended), Spain (ended).
Therapeutic area(s): Diseases [C] - Immune System Diseases [C20]
Gender: Female, Male. Age: 18-64 years, 65+ years. Enrolment: 57.
Status: Ended. Start date (EU): 2020-11-11. End date (EU): 2024-12-10. End date: 2025-01-05. Decision date: 2024-08-07. Results received: Yes. Last updated: 2024-09-04.
Decision dates by country: DE: 2024-08-08, FR: 2024-08-08, ES: 2024-08-07, PL: 2024-08-29

Condition(s): Bullous Pemphigoid
Product: PREDNISOLONE, Dupixent 300 mg solution for injection in pre-filled syringe, Placebo matching to dupilumab

Primary endpoint: Proportion of patients achieving sustained remission.
Endpoint(s): Total cumulative dose of oral corticosteroids (OCS)., Percent change in weekly average of daily peak pruritus numerical rating score (NRS)., Proportion of patients with improvement (reduction) of weekly average of daily peak pruritus NRS ≥4., Percent change in Bullous Pemphigoid Disease Area Index Activity Score (BPDAI) activity score., Time to first use of rescue medication., Duration of complete remission while not requiring OCS., Proportion of patients who do not achieve control of disease activity, who relapse after achieving control of disease activity, or do not achieve complete remission., Proportion of patients who achieve a reduction in BPDAI activity score of at least 50%, 75%, and 90%., Change in autoimmune bullous disease quality of life (ABQOL)., Change in percent body surface area (BSA) of BP involvement., Change in BP180 autoantibody (IgG) titers., Change in BP230 autoantibody (IgG) titers., Proportion of patients with sustained remission., Total cumulative dose of OCS., Duration of complete remission while not requiring OCS., Percent change in weekly average of daily peak pruritus NRS., Percent change in BPDAI activity score., Change in ABQOL., Change in percent BSA of BP involvement., Proportion of patients in complete remission and off OCS., Incidence of treatment-emergent adverse events (TEAEs)., Incidence of treatment-emergent serious adverse events (SAEs)., Incidence of adverse events of special interest (AESIs)., Concentrations of functional dupilumab in serum., Incidence of treatment-emergent anti-drug antibody (ADA) responses and titer.

Source: https://euclinicaltrials.eu/ctis-public/view/2024-510745-34-00